EU clinical trial 2024-512520-11-00: An open-label, phase I/II multicenter clinical trial of NECVAX-NEO1 as add-on to first-line neoadjuvant anti-PD-1 monoclonal antibody therapy in patients with triple-negative breast cancer
Protocol code: NECVAX-NEO1-05-DE
Sponsor: NEC Bio Therapeutics GmbH (Pharmaceutical company). Phase: Phase I and Phase II (Integrated)- Other. Countries: Germany (ongoing, recruiting).
Therapeutic area(s): Diseases [C] - Neoplasms [C04]
Gender: Female, Male. Age: 18-64 years, 65+ years. Enrolment: 28.
Status: Ongoing, recruiting. Start date (EU): 2024-11-19. Decision date: 2024-08-06. Results received: No. Last updated: 2026-05-19.

Condition(s): Triple negative breast cancer (TNBC)
Product: Abraxane 5 mg/ml powder for dispersion for infusion.

Primary endpoint: Reported adverse events (AEs) and serious adverse events (SAEs), Changes from Baseline in laboratory parameters (hematology, biochemistry, coagulation, and urinalysis), physical examinations, vital signs, and electrocardiograms (ECGs) during the Treatment and Follow-up periods.
Endpoint(s): Pathological complete response (pCR), defined as the absence of residual invasive cancer on hematoxylin and eosin evaluation of the complete resected breast specimen and all sampled regional lymph nodes following completion of neoadjuvant systemic therapy (i.e., ypT0/Tis ypN0 in the current American Joint Committee on Cancer (AJCC) system), Residual cancer burden (RCB) as a determinant of the extent of residual disease in post-surgery. Six variables are included in the formula. An RCB index value can also be calculated and involves the categorization into one of four RCB classes (RCB 0 or pCR, RCB I or near pCR, RCB II, RCB III), Changes in ctDNA assessments compared to pre-treatment, Event-free survival (EFS), defined as the time from first dose of NECVAX-NEO1 to any of the following events: progression of disease that precludes surgery, local or distant recurrence, or death due to any cause up to the end of the safety follow-up at 24 months, Invasive disease-free survival (iDFS), defined as the time from first dose of NECVAX-NEO1 until local or distant recurrence or death due to any cause up to the end of the safety follow-up at 24 months, (Exploratory) Tumor tissue evaluations at Baseline, and at surgery (Week 12) compared to Screening, including effector T-cell infiltration, regulatory T-cells (Treg), Myeloid Derived Suppressor Cells (MDSC), PD-1, and mutational burden, (Exploratory) Correlation between ctDNA and clinical efficacy/OS endpoints, (Exploratory) Intestinal microbiome evaluation at Week 12, Week 24 and Week 36 (in case of optional prolongation) compared to Baseline, (Exploratory) Clinical efficacy and OS endpoints, using pre-treatment as a reference date for changes, where applicable. Treatment response will also be assessed based on changes in tumor burden, (Exploratory) Overall survival (OS), defined as the time from first NECVAX-NEO1 administration to death, (Exploratory) Clinical efficacy based on available RECIST 1.1 and iRECIST assessments: Objective response rate (ORR): proportion of patients having a best overall response (BOR) of complete response (CR) or partial response (PR) relative to assessment at the Screening visit

Source: https://euclinicaltrials.eu/ctis-public/view/2024-512520-11-00